EU clinical trial 2024-511261-11-00: A randomized Phase 2, double-blind, placebo-controlled, parallel-group, 2-arm study to assess the efficacy, safety, and tolerability of subcutaneous lunsekimig in adult participants with chronic rhinosinusitis with nasal polyps (CRSwNP)
Protocol code: ACT18207
Sponsor: Sanofi-Aventis Recherche & Developpement (Pharmaceutical company). Phase: Therapeutic exploratory (Phase II). Countries: Bulgaria (ended), Poland (ended), Belgium (ended).
Therapeutic area(s): Diseases [C] - Respiratory Tract Diseases [C08]
Gender: Female, Male. Age: 18-64 years, 65+ years. Enrolment: 77.
Status: Ended. Start date (EU): 2025-03-05. End date (EU): 2026-04-09. End date: 2026-04-23. Decision date: 2024-08-20. Results received: No. Last updated: 2025-09-23.
Decision dates by country: BE: 2024-08-20, PL: 2024-08-26, BG: 2024-08-26

Condition(s): Respiratory tract diseases
Product: SAR443765 / LUNSEKIMIG, Matched Placebo to Test, MOMETASONE

Primary endpoint: Change in bilateral endoscopic nasal polyp score (NPS)
Endpoint(s): Change in patient-reported nasal congestion/obstruction score, Change in Lund-Mackay CT score, Change in the percent of maxillary sinus volume occupied by disease on CT scan, Change in SNOT-22 total score, Change in patient-reported total symptom score (nasal congestion/obstruction, anterior or posterior rhinorrhea, and loss of smell), Change in patient-reported anterior rhinorrhea and posterior rhinorrhea score, Change in rhinosinusitis visual analog scale (VAS), Change in University of Pennsylvania Smell Identification Test (UPSIT) score, Change in patient-reported loss of smell score, Serum lunsekimig concentrations, Anti-drug antibodies (ADA) against lunsekimig, Incidence of participants with treatment-emergent adverse events (TEAEs), Incidence of participants with adverse events of special interest (AESI), Incidence of participants with serious adverse events (SAEs), Change in asthma control questionnaire (ACQ-5), Change in pre-bronchodilator forced expiratory volume in the first second (pre-BD FEV1), Change in pre-BD percent predicted FEV1

Source: https://euclinicaltrials.eu/ctis-public/view/2024-511261-11-00